EU clinical trial 2025-521582-27-00: A PHASE 1B, OPEN-LABEL, DOSE ESCALATION WITH AN EXPANSION TRIAL OF A IN COMBINATION WITH B OR A PLUS STANDARD OF CARE IN PATIENTS WITH XXX CANCER ELIGIBLE FOR SECOND LINE TREATMENT
Protocol code: LCB-2301-002
Sponsor: NovImmune S.A. (Pharmaceutical company). Phase: Human Pharmacology (Phase I)- Other. Countries: Spain (ongoing, recruitment ended).
Therapeutic area(s): Diseases [C] - Neoplasms [C04]
Gender: Female, Male. Age: 18-64 years, 65+ years. Enrolment: 60.
Status: Ongoing, recruitment ended. Start date (EU): 2025-07-03. Decision date: 2025-06-30. Results received: No. Last updated: 2025-06-30.

Condition(s): XXX CANCER ELIGIBLE FOR SECOND LINE TREATMENT

Source: https://euclinicaltrials.eu/ctis-public/view/2025-521582-27-00